EU clinical trial 2023-507941-28-00: A study in healthy men to test how different doses of BI 3031185 are tolerated and how food influences the amount of BI 3031185 in the blood
Protocol code: 1516-0001
Sponsor: Boehringer Ingelheim International GmbH (Pharmaceutical company). Phase: Human Pharmacology (Phase I)- First administration to humans. Countries: Germany (ended).
Therapeutic area(s): Not possible to specify
Gender: Male. Age: 18-64 years. Enrolment: 76.
Status: Ended. Start date (EU): 2024-03-08. End date (EU): 2024-08-28. Decision date: 2024-02-16. Results received: No. Last updated: 2024-02-16.

Condition(s): Healthy volunteer trial

Source: https://euclinicaltrials.eu/ctis-public/view/2023-507941-28-00